EU clinical trial 2023-507901-32-00: A study to characterize the safety, efficacy, pharmacokinetics of subcutaneous administration of Etentamig (ABBV-383) in patients with relapsed or refractory Multiple Myeloma
Protocol code: M23-001
Sponsor: AbbVie Deutschland GmbH & Co. KG (Pharmaceutical company). Phase: Human Pharmacology (Phase I)- Other. Countries: France (not authorised), Germany (ongoing, recruitment ended).
Therapeutic area(s): Diseases [C] - Neoplasms [C04]
Gender: Female, Male. Age: 18-64 years, 65+ years. Enrolment: 30.
Start date (EU): 2024-06-28. Decision date: 2024-05-13. Results received: No. Last updated: 2026-04-20.
Decision dates by country: FR: 2024-05-14, DE: 2024-05-13

Condition(s): Relapsed or Refractory Multiple Myeloma (R/R MM)

Source: https://euclinicaltrials.eu/ctis-public/view/2023-507901-32-00